EU clinical trial 2025-523995-21-00: A study to investigate the effect of capivasertib on the pharmacokinetics of oral dextromethorphan (CYP2D6) in healthy participants
Protocol code: D3615C00005
Sponsor: AstraZeneca AB (Pharmaceutical company). Phase: Human Pharmacology (Phase I)- Other. Countries: Germany (ended).
Therapeutic area(s): Not possible to specify
Gender: Female, Male. Age: 18-64 years. Enrolment: 42.
Status: Ended. Start date (EU): 2026-01-27. End date (EU): 2026-07-20. Decision date: 2026-01-26. Results received: No. Last updated: 2026-07-14.

Condition(s): Healthy participants

Source: https://euclinicaltrials.eu/ctis-public/view/2025-523995-21-00